EU clinical trial 2023-506415-18-00: An Open-Label Study of Brentuximab Vedotin+Adriamycin, Vinblastine, and Dacarbazine in Pediatric Patients With Advanced Stage Newly Diagnosed Hodgkin Lymphoma
Protocol code: C25004
Sponsor: Takeda Development Center Americas Inc. (Pharmaceutical company). Phase: Phase I and Phase II (Integrated)- Other. Countries: Italy (ongoing, recruitment ended).
Therapeutic area(s): Diseases [C] - Neoplasms [C04]
Gender: Female, Male. Age: 0-17 years. Enrolment: 15.
Status: Ongoing, recruitment ended. Start date (EU): 2017-07-18. Decision date: 2024-01-17. Results received: No. Last updated: 2026-02-04.

Condition(s): Hodgkin lymphoma (HL) - Hodgkin lymphoma (HL), a neoplasm of lymphoid tissue which is histopathologically defined by the presence of malignant Hodgkin Reed-Sternberg (HRS) cells in a background of inflammatory cells. The proposed pediatric study has been designed to evaluate brentuximab vedotin as a component of a multiagent frontline chemotherapy regimen in patients with advanced stage, newly diagnosed HL, here defined as Stage III and Stage IV and a ≥50 Lansky Play-Performance or Karnofsky Performance Status.
Product: ADCETRIS 50 mg powder for concentrate for solution for infusion

Primary endpoint: Phase 1: Determination of the recommended dose of brentuximab vedotin in combination with AVD in a pediatric population., Phase 1: Percentage of patients who experience AEs from the first dose of protocol therapy through 30 days after administration of the last dose of protocol therapy., Phase 1: Percentage of patients who experience serious AEs (SAEs) from the first dose of protocol therapy through 30 days after administration of the last dose of protocol therapy., Phase 2: Percentage of patients who achieve a CR per IRF assessment at EOT per IWG criteria., Phase 2: Percentage of patients whose disease is PET- after 2 cycles of protocol therapy per IRF assessment., Phase 2: Percentage of patients who achieve a PR per IRF assessment at EOT per IWG criteria., Phase 2: Percentage of patients who achieve an OR per IRF assessment at EOT per IWG criteria., Phase 2: Percentage of patients who are able to complete 6 cycles of protocol therapy at the recommended dose.
Endpoint(s): Phase 1: Mean Cmax and mean AUC0-15 of brentuximab vedotin (serum), TAb (serum), and MMAE (plasma)., Phase 1: Median Tmax of brentuximab vedotin (serum), TAb (serum), and MMAE (plasma)., Phase 1: Percentage of patients who achieve a CR per independent review facility (IRF) assessment at End of Treatment (EOT) per International Working Group (IWG) criteria., Phase 1: Percentage of patients who achieve a PR per IRF assessment at EOT per IWG criteria., Phase 1: Percentage of patients who achieve an overall response (OR) per IRF assessment at EOT per IWG criteria., Phase 1: Percentage of patients whose disease is PET- after 2 cycles of protocol therapy per IRF assessment., Phase 1: Percentage of patients whose disease is PET+ after 6 cycles of protocol therapy per IRF assessment., Phase 1: Percentage of patients who are ATA positive, persistently positive, or transiently positive, ATA titer and neutralizing ATA (nATA) positive at baseline, predose Cycle 2 Day 1, Cycle 4 Day 1, Cycle 6 Day 1, or at termination if treatment is terminated before Cycle 6, and at EOT, Phase 1: Impact of ATA and nATA on the safety, efficacy, and PK endpoints., Phase 2: PFS, EFS, OS, DOR., Phase 2: Percentage of patients receiving irradiation for HL following study treatment., Phase 2: Percentage of patients who experience AEs from the first dose of protocol therapy through 30 days after administration of the last dose of protocol therapy., Phase 2: Percentage of patients who experience SAEs from the first dose of protocol therapy through 30 days after administration of the last dose of protocol therapy., Phase 2: Percentage of patients who are ATA positive, persistently positive, or transiently positive, ATA titer and nATA positive at baseline, predose Cycle 2 Day 1, Cycle 4 Day 1, Cycle 6 Day 1, or at termination if treatment is terminated before Cycle 6, and at EOT., Phase 2: Impact of ATA and nATA on the safety, efficacy, and PK endpoints., Phase 2: Mean Cmax and mean AUC0-15 of brentuximab vedotin (serum), TAb (serum), and MMAE (plasma)., Phase 2: Median Tmax of brentuximab vedotin (serum), TAb (serum), and MMAE (plasma)., Phase 2: Percentage of patients who experience peripheral neuropathy, regardless of seriousness, from the first dose of protocol therapy through study closure., Phase 2: Time to onset and time to resolution for all peripheral neuropathy events., Phase 2: Immune reconstitution (peripheral blood CD34+ count; enumeration of the total lymphocyte count and lymphocyte subsets; total Ig and IgG, IgM, and IgA levels; and levels of the antibodies to tetanus, HiB, and polio serotypes) at baseline, EOT, and at 6, 12, and 18 months (±1 month) after last dose, until the start of subsequent anticancer therapy (with the exception of radiotherapy administered as part of first-line therapy).

Source: https://euclinicaltrials.eu/ctis-public/view/2023-506415-18-00